EU clinical trial 2022-502362-24-00: Methotrexate treatment in hand osteoarthritis refractory to usual treatments: A randomised, double-blind, placebo-controlled trial, ADEM2 study
Protocol code: 21-API-03
Sponsor: Centre Hospitalier Universitaire De Nice (Hospital/Clinic/Other health care facility). Phase: Therapeutic exploratory (Phase II). Countries: France (authorised, recruiting).
Therapeutic area(s): Diseases [C] - Musculoskeletal Diseases [C05]
Gender: Female, Male. Age: 18-64 years, 65+ years. Enrolment: 170.
Status: Authorised, recruiting. Start date (EU): 2026-06-30. Decision date: 2025-10-17. Results received: No. Last updated: 2026-06-04.

Condition(s): Erosive osteoarthritis
Product: SODIUM CHLORIDE SOLUTION 0.9%, SPECIAFOLDINE 5 mg, comprimé, METOJECT 15 mg / 0,30 ml, solution injectable en stylo prérempli

Primary endpoint: Structural damage is assessed using the Verbruggen-Veys score. The evolution of structural damage between M0 and M12, or worsening, of digital osteoarthritis of a joint will be defined by the change in stage of the Verbruggen-Veys score by at least one level

Source: https://euclinicaltrials.eu/ctis-public/view/2022-502362-24-00